EU clinical trial 2024-520131-33-00: Effect of H2 inhalation therapy on early recurrence after atrial fibrillation ablation. Multicenter, open-label, randomized phase II controlled trial.
Protocol code: 38RC22.0404
Sponsor: Centre Hospitalier Universitaire Grenoble Alpes (Hospital/Clinic/Other health care facility). Phase: Therapeutic exploratory (Phase II). Countries: France (authorised, recruitment pending).
Therapeutic area(s): Diseases [C] - Cardiovascular Diseases [C14]
Gender: Female, Male. Age: 18-64 years, 65+ years. Enrolment: 136.
Status: Authorised, recruitment pending. Decision date: 2026-02-25. Results received: No. Last updated: 2026-02-25.

Condition(s): atrial fibrillation
Product: Mélange gazeux H2/ N2 3,6%/96,4%

Primary endpoint: The primary endpoint is binary and composite, defined as: - The absence of early recurrence during the blanking period (3 months post-ablation), defined as any episode of AF, atrial flutter, or atrial tachycardia lasting at least 30 seconds AND - Improvement in quality of life defined as a decrease in the AFEQT (Atrial Fibrillation Effect on Quality of Life) score of at least 5 points (72) between D0 and M3.
Endpoint(s): Number of hospitalizations or electrical cardioversions or drug-induced cardioversions during the blanking period, Late recurrence (> 3 months and up to 12 months after ablation), Variation in blood concentration of inflammation markers (GB, CRPus, and IL-6) between 24 hours pre-ablation and 24–48 hours post-ablation, Collection of adverse events that will be described and graded using the Common Terminology Criteria for Adverse Events v5.0 (CTCAE) terminology., Customized questionnaire on patient acceptance of hydrogen therapy treatment upon admission to the hospital (part 1) and upon discontinuation of hydrogen therapy (part 2), Customized hetero-questionnaire on healthcare providers' acceptance of hydrogen therapy treatment

Source: https://euclinicaltrials.eu/ctis-public/view/2024-520131-33-00